EU clinical trial 2022-501354-10-01: A Phase 3 randomized, placebo-controlled, double-blind, parallel-group program to evaluate efficacy and safety of filgotinib in adult subjects with active axial spondyloarthritis
Protocol code: GLPG0634-CL-336
Sponsor: Alfasigma S.p.A. (Pharmaceutical company). Phase: Therapeutic confirmatory (Phase III). Countries: Romania (ended), Germany (ongoing, recruitment ended), Lithuania (ended), Netherlands (ended), Italy (ended), Estonia (ended), Greece (ended), Poland (ongoing, recruitment ended), France (ended), Belgium (ended), Spain (ongoing, recruitment ended), Czechia (ongoing, recruitment ended), Bulgaria (ended), Croatia (ended), Hungary (ended).
Therapeutic area(s): Diseases [C] - Musculoskeletal Diseases [C05]
Gender: Female, Male. Age: 18-64 years, 65+ years. Enrolment: 487.
Start date (EU): 2023-06-21. Decision date: 2023-05-10. Results received: No. Last updated: 2026-06-29.
Decision dates by country: HR: 2023-05-16, GR: 2023-05-16, LT: 2023-05-11, HU: 2023-05-18, RO: 2023-05-15, IT: 2023-05-15, BE: 2023-05-15, EE: 2023-05-12, FR: 2023-05-10, BG: 2023-05-22, NL: 2023-05-11, PL: 2023-05-22, CZ: 2023-05-12, ES: 2023-05-10, DE: 2023-05-10

Condition(s): axial spondyloarthritis
Product: Jyseleca 100 mg film-coated tablets, Placebo-to-match (PTM) tablets will be used in this trial to maintain blinding of the active dose. PTM 200 mg and 100 mg filgotinib tablets are identical in appearance to the respective active filgotinib tablets., Jyseleca 200 mg film-coated tablets

Primary endpoint: To compare the efficacy of filgotinib 200 mg versus placebo at week 16 on achieving ASAS40 response (Y/N)
Endpoint(s): To compare the efficacy of filgotinib 200 mg versus placebo at week 16 on change from baseline in Ankylosing Spondylitis Disease Activity Score with C-reactive protein (ASDASCRP), To compare the efficacy of filgotinib 200 mg versus placebo at week 16 on change from baseline in Spondyloarthritis Research Consortium of Canada (SPARCC) magnetic resonance imaging (MRI) score of sacroiliac joints (SIJs), To compare the efficacy of filgotinib 200 mg versus placebo at week 16 on change from baseline in Bath Ankylosing Spondylitis Functional Index (BASFI), To compare the efficacy of filgotinib 200 mg versus placebo at week 16 on change from baseline in Ankylosing Spondylitis Quality of Life (ASQoL), To compare the efficacy of filgotinib 200 mg versus placebo at week 16 on change from baseline in Bath Ankylosing Spondylitis Metrology Index (BASMI) (linear score), To compare the efficacy of filgotinib 200 mg versus placebo at week 16 on frequency and severity of treatment-emergent adverse events (TEAEs), treatment-emergent serious adverse events (SAEs), and TEAEs leading to treatment discontinuation

Source: https://euclinicaltrials.eu/ctis-public/view/2022-501354-10-01